EU clinical trial 2023-507683-40-00: Randomized control trial comparison between intra-articular infiltrations of PRP, MFAT, and PRP-MFAT in the treatment of symptomatic knee osteoarthritis.
Protocol code: MICROPREP III
Sponsor: Assistance Publique Hopitaux De Marseille (Hospital/Clinic/Other health care facility). Phase: Therapeutic confirmatory (Phase III). Countries: France (authorised, recruitment pending).
Therapeutic area(s): Diseases [C] - Musculoskeletal Diseases [C05]
Gender: Female, Male. Age: 18-64 years, 65+ years. Enrolment: 180.
Status: Authorised, recruitment pending. Decision date: 2024-05-29. Results received: No. Last updated: 2026-03-03.

Condition(s): knee osteoarthritis

Source: https://euclinicaltrials.eu/ctis-public/view/2023-507683-40-00